EU clinical trial 2024-520346-39-00: A randomised, double-blind, multicenter, placebo-controlled clinical trial of colchicine to reduce coronary artery inflammation in people with HIV. COLCOHIV
Protocol code: COLCOHIV
Sponsor: Fundacion Para La Investigacion Biomedica Del Hospital Universitario La Paz (Patient organisation/association). Phase: Therapeutic exploratory (Phase II). Countries: Spain (ongoing, recruiting).
Therapeutic area(s): Diseases [C] - Virus Diseases [C02]; Diseases [C] - Cardiovascular Diseases [C14]
Gender: Female, Male. Age: 18-64 years, 65+ years. Enrolment: 104.
Status: Ongoing, recruiting. Start date (EU): 2026-06-22. Decision date: 2025-04-25. Results received: No. Last updated: 2026-06-05.

Condition(s): High cardiovascular risk in HIV patients
Product: COLCHICINA SEID 0,5 mg comprimidos, Placebo Colchicina SEID

Primary endpoint: Percent change from baseline of the mean Fat Attenuation Index (FAI) score for the 3 coronary arteries (RCA, LAD, LCX), calculated as the average of the analyzable FAI scores (valid baseline and post-baseline FAI score) across the three main coronary arteries
Endpoint(s): Changes in plaque volume and plaque burden assessed by CCTA in week 96., Changes in plaque morphology (non-calcified, mixed, calcified) assessed by CCTA in week 96, Changes in the percentage of high-risk plaques (positive remodelling, spotty calcium, napky ring sign and low attenuation plaque) assessed by CCTA in week 96, Changes in serum inflammatory markers (hsPCR, IL-6, IL-1 beta, IL-18, SuPAR) in week 96, Changes in inflammasome markers in extracellular vesicles (NLRP3, ASC, Caspase-1) in week 96, Changes in differential monocytes subpopulations (classic CD14++CD16-, non-classic CD14++CD16++ and intermediate CD14+CD16+) in week 96, Percentage change of leukocyte count in week 96, Solicited and unsolicited AEs in all participants throughout the trial, Serious adverse events (SAEs) in all participants, Change from baseline for FAI, FAI score (mean absolute change and mean percent change) and FAI score centile in the following vessels: Greatest change in most inflamed vessel, Greatest change in any vessel , RCA only analysis, LAD only analysis, LCX only analysis, Mean absolute change from baseline for mean FAI and mean FAI score, defined as the average of the analyzable vessels (with valid baseline FAI and post-baseline FAI) across the three main coronary arteries (RCA, LAD, LCX), Differences in FAI percentage change between males and females in both treatment groups assessed by CCTA in week 96, Differences in FAI percentage change by CYP2D6 genotype in the treatment group, Differences in MACE between colchicine and placebo groups assessed clinically in week 96, Change from baseline for CaRi-Heart risk score (mean absolute change and mean percent change.

Source: https://euclinicaltrials.eu/ctis-public/view/2024-520346-39-00